EU clinical trial 2024-516157-41-00: A multicentre phase II, single arm study of Durvalumab (MEDI 4736) with Carboplatin plus Etoposide for 4 cycles followed by Durvalumab maintenance in patients with metastatic pulmonary large-cell neuroendocrine carcinoma (LCNEC) – DUPLE trial
Protocol code: GOIRC-05-2020
Sponsor: G.O.I.R.C. Gruppo Oncologico Italiano Di Ricerca Clinica (Patient organisation/association). Phase: Therapeutic exploratory (Phase II). Countries: Italy (ongoing, recruitment ended).
Therapeutic area(s): Diseases [C] - Neoplasms [C04]
Gender: Female, Male. Age: 18-64 years, 65+ years. Enrolment: 49.
Status: Ongoing, recruitment ended. Start date (EU): 2022-05-27. Decision date: 2024-10-28. Results received: No. Last updated: 2024-10-28.

Condition(s): Metastatic pulmonary large-cell neuroendocrine carcinoma (LCNEC)
Product: ETOPOSIDE, IMFINZI 50 mg/mL concentrate for solution for infusion., CARBOPLATIN

Primary endpoint: The primary endpoint is Overall Survival (OS) that will be measured from the date of registration to the date of death by any cause and will be analyzed as survival rate at 1 year
Endpoint(s): Median OS that will be measured from the date of registration to the date of death by any cause, Progression Free Survival (PFS) that will be measured from the date of registration to the date of disease progression, based on the Investigator’s assessment according to standard RECIST 1.1 criteria, or death and reported as median PFS and 6-month and 12-month PFS rate., Objective Response Rate (ORR) that will be defined as the sum of complete response (CR) + partial response (PR), based on the Investigator’s assessment according to standard RECIST 1.1 criteria. Patients with no tumor assessment after baseline will be classified as non-responders, Median Duration of Response (DoR) that will be measured from the date of first radiological evidence PR or CR to the date of first evidence of PD, both based on the Investigator’s assessment according to standard RECIST 1.1 criteria, Disease control rate (DCR) that will be considered as the sum of complete responses (CRs), partial responses (PRs) and stable disease (SD), according to standard RECIST 1.1 criteria. Patients with no tumor assessment after baseline will be classified as non-responders, Toxicity that will be based mainly on the frequency and severity of adverse events (all grades and grade 3-4); severity will be measured according to NCI Common Terminology Criteria Adverse Event (CTCAE), version 5.0. The worst severity grade adverse event will be considered for each patient

Source: https://euclinicaltrials.eu/ctis-public/view/2024-516157-41-00